EU clinical trial 2023-506830-66-00: A dose-finding trial evaluating the effect and safety of once-weekly treatment of somapacitan compared to daily Norditropin® in children with short stature born small for gestational age with no catch-up growth by 2 years of age or older
Protocol code: NN8640-4245
Sponsor: Novo Nordisk A/S (Pharmaceutical company). Phase: Therapeutic exploratory (Phase II). Countries: Hungary (ongoing, recruitment ended), Austria (ongoing, recruitment ended), Italy (ongoing, recruitment ended), Latvia (ended), France (ongoing, recruitment ended).
Therapeutic area(s): Diseases [C] - Hormonal diseases [C19]
Gender: Female, Male. Age: 0-17 years. Enrolment: 10.
Start date (EU): 2019-05-29. Decision date: 2024-05-07. Results received: No. Last updated: 2026-07-16.
Decision dates by country: LV: 2024-05-07, HU: 2024-05-08, IT: 2024-05-08, FR: 2024-06-11, AT: 2024-05-08

Condition(s): SGA - small for gestational age children
Product: Sogroya 15 mg/1.5 mL solution for injection in pre-filled pen, Sogroya 10 mg/1.5 mL solution for injection in pre-filled pen, Sogroya 5 mg/1.5 mL solution for injection in pre-filled pen, Norditropin FlexPro, injektionsvæske, opløsning i fyldt pen

Primary endpoint: Endpoint title: Height velocity (HV) Time frame: From baseline (week 0) to visit 6 (week 26) Unit: cm/year
Endpoint(s): Effect Endpoint title: Change in bone age Time frame: From baseline (week 0) to visit 8 (week 52) Unit: Years, Effect Endpoint title: Change in height SDS Time frame: From baseline (week 0) to visit 6 (week 26) Unit: -10 to +10, Effect Endpoint title: Change in Height velocity SDS Time frame: From baseline (week 0) to visit 6 (week 26) Unit: -10 to +10, Safety Endpoint title: Change in fasting plasma glucose Time frame: From screening (visit 1) to visit 6 (week 26) Unit: mmol/l, Safety Endpoint title: Change in homeostatic model assessment (HOMA) Time frame: From screening (visit 1) to visit 6 (week 26) Unit: %, Safety Endpoint title: Change in Glycated haemoglobin (HbA1c) Time frame: From screening (visit 1) to visit 6 (week 26) Unit: % point, Pharmacodynamics Endpoint title: Change in IGF-I SDS Time frame: From baseline (week 0) to visit 6 (week 26) Unit: -10 to +10, Pharmacodynamics Endpoint title: Change in IGFBP-3 SDS Time frame: From baseline (week 0) to visit 6 (week 26) Unit: -10 to +10

Source: https://euclinicaltrials.eu/ctis-public/view/2023-506830-66-00